EU clinical trial 2022-501687-18-00: INCB 50465-801: A Phase 2, Open-Label, Multicenter, Rollover Study to Provide Continued Treatment for Participants Previously Enrolled in Studies of Parsaclisib (INCB050465)
Protocol code: INCB 50465-801
Sponsor: Incyte Corp. (Pharmaceutical company). Phase: Therapeutic exploratory (Phase II). Countries: Italy (ongoing, recruitment ended), Denmark (ended), Spain (ongoing, recruitment ended), France (ongoing, recruitment ended), Belgium (ongoing, recruitment ended), Poland (ongoing, recruitment ended), Czechia (ongoing, recruitment ended), Sweden (ended).
Therapeutic area(s): Diseases [C] - Immune System Diseases [C20]; Diseases [C] - Neoplasms [C04]
Gender: Female, Male. Age: 18-64 years, 65+ years. Enrolment: 144.
Start date (EU): 2020-10-28. Decision date: 2023-01-31. Results received: No. Last updated: 2026-04-07.
Decision dates by country: SE: 2024-04-08, BE: 2023-01-31, DK: 2023-01-31, FR: 2023-02-03, IT: 2023-01-31, ES: 2023-01-31, PL: 2024-04-10, CZ: 2024-04-03

Condition(s): Advanced malignancies and IAI diseases
Product: IMBRUVICA 140 mg hard capsules, Parsaclisib (INCB050465), Parsaclisib (INCB050465), Jakavi 5 mg tablets, Parsaclisib (INCB050465), MINJUVI 200 mg powder for concentrate for solution for infusion, IMBRUVICA 140 mg hard capsules, Parsaclisib (INCB050465)

Primary endpoint: To assess AEs and SAEs reported in participants receiving parsaclisib as monotherapy or in combination with itacitinib, ruxolitinib, ibrutinib, or tafasitamab (including participants who remain on tafasitamab alone).

Source: https://euclinicaltrials.eu/ctis-public/view/2022-501687-18-00